EU clinical trial 2024-515755-37-00: A randomized phase II study comparing atezolizumab after concurrent chemoradiotherapy with chemoradiotherapy alone in limited disease small-cell lung cancer
Protocol code: ACHILES
Sponsor: Norwegian University Of Science And Technolology (Educational Institution). Phase: Therapeutic exploratory (Phase II). Countries: Sweden (ongoing, recruitment ended), Denmark (ongoing, recruitment ended), Lithuania (ongoing, recruitment ended), Norway (ongoing, recruitment ended), Netherlands (ongoing, recruitment ended).
Therapeutic area(s): Diseases [C] - Neoplasms [C04]
Gender: Female, Male. Age: 18-64 years, 65+ years. Enrolment: 195.
Status: Ongoing, recruitment ended. Start date (EU): 2018-07-31. Decision date: 2024-10-11. Results received: No. Last updated: 2026-06-05.
Decision dates by country: DK: 2024-10-11, LT: 2024-10-24, NL: 2024-10-11, NO: 2024-10-13, SE: 2024-10-11

Condition(s): Limited disease small-cell lung cancer
Product: Tecentriq 1 200 mg concentrate for solution for infusion

Primary endpoint: Overall survival
Endpoint(s): Best response rates (best response observed through the whole study period), Progression free survival, Toxicity, Health related quality of life

Source: https://euclinicaltrials.eu/ctis-public/view/2024-515755-37-00